EU clinical trial 2024-513384-15-00: A Phase 2a, Multicenter, Randomized, Double-Blind, Placebo Controlled Study to Evaluate the Safety and Pharmacodynamic Effects of BIIB122 in Participants With LRRK2-Associated Parkinson’s Disease (LRRK2-PD)
Protocol code: DNLI-C-0009
Sponsor: Denali Therapeutics Inc. (Pharmaceutical company). Phase: Therapeutic exploratory (Phase II). Countries: Spain (ongoing, recruitment ended), Germany (ongoing, recruitment ended).
Therapeutic area(s): Diseases [C] - Nervous System Diseases [C10]
Gender: Female, Male. Age: 18-64 years, 65+ years. Enrolment: 27.
Status: Ongoing, recruitment ended. Start date (EU): 2025-02-13. Decision date: 2024-11-25. Results received: No. Last updated: 2026-04-01.
Decision dates by country: ES: 2024-12-05, DE: 2024-11-25

Condition(s): Parkinson’s disease
Product: BIIB122, Placebo to BIIB122

Primary endpoint: Incidence of TEAEs and SAEs with BIIB122 compared with placebo over the 12-week double-blind period
Endpoint(s): Change from baseline in whole-blood pS935 LRRK2 with BIIB122 compared with placebo at Week 12, Change from baseline in urine BMP with BIIB122 compared with placebo at Week 12

Source: https://euclinicaltrials.eu/ctis-public/view/2024-513384-15-00